EU clinical trial 2023-509699-41-00: An Open-Label, Single-Arm, Phase 1/2 Study Evaluating the Safety and Efficacy of Ponatinib for the Treatment of Recurrent or Refractory Leukemias or Solid Tumors in Pediatric Participants
Protocol code: INCB 84344-102
Sponsor: Incyte Biosciences International S.a.r.l. (Pharmaceutical company). Phase: Phase I and Phase II (Integrated)- Other. Countries: Belgium (ongoing, recruiting), Sweden (ongoing, recruiting), Spain (ongoing, recruiting), France (ongoing, recruiting), Italy (ongoing, recruiting), Netherlands (ongoing, recruiting).
Therapeutic area(s): Diseases [C] - Hemic and Lymphatic Diseases [C15]
Gender: Female, Male. Age: 0-17 years. Enrolment: 57.
Status: Ongoing, recruiting. Start date (EU): 2019-11-22. Decision date: 2024-01-29. Results received: No. Last updated: 2026-07-15.
Decision dates by country: NL: 2024-02-01, SE: 2024-01-29, ES: 2024-01-29, IT: 2024-03-12, BE: 2024-02-01, FR: 2024-02-05

Condition(s): Recurrent or Refractory Leukemias, Lymphomas, and Solid Tumors
Product: Iclusig 15 mg film-coated tablets, Iclusig 45 mg film-coated tablets, Ponatinib, Iclusig 15 mg film-coated tablets, Iclusig 15 mg film-coated tablets, Iclusig 30 mg film-coated tablets., Ponatinib, Iclusig 45 mg film-coated tablets, Ponatinib

Primary endpoint: Phase 1 Dose Escalation Determination of DLTs during the DLT evaluation period (first 28 days of treatment). Phase 2 Expansion Group A (CP-CML): MCyR, defined as CCyR or PCyR by 12 months, assessed by conventional cytogenetics or FISH., Group B (Other Tumors): Hematologic malignancies: • BCR-ABL–positive leukemias (CML in AP or BP; Ph+ ALL): MaHR or MMR assessed by q-PCR by 3 months. • Other leukemias: CR, CRi, as assessed by conventional cytogenetics, FISH, or q-PCR. • Lymphoma: CR according to Lugano criteria (Cheson et al 2014) based on CT or MRI (or PET)., Solid tumors: • ORR, defined as the percentage of participants having CR or PR, as determined by investigator assessment of radiographic disease per tumors per RANO for CNS tumors or RECIST v1.1 for other solid tumors based on CT or MRI (or PET).
Endpoint(s): − Phase 1 Dose Escalation: • Frequency and severity of AEs and SAEs. • Changes in vital signs and clinical evaluations. • Changes in clinical laboratory blood samples. • PK parameters: Tmax, AUCss,0-24, t½, CLss/F, Vz/F., Phase 2 Expansion Group A (CP-CML): • CHR at 6 months. • CCyR at 12 months. • MMR at 12 months. • TTR, defined as the interval from the date of the first dose of study treatment to first response., DOR, defined as the interval between the first assessment at which the criteria for response are met until the criteria for progression are met. • PFS, defined as defined as the interval from the date of the first dose of study treatment until the date of progression of disease or death from any cause, whichever is earlier., • OS, defined as the interval from the date of first dose of study treatment until death from any cause., Group B (Other Tumors): Hematologic malignancies: BCR-ABL–positive leukemias (CML in AP or BP; Ph+ ALL): MaHR or MMR by 3 months. • Other leukemias: CR., CRi, as assessed by conventional cytogenetics, FISH, or q-PCR. • Lymphoma: CR according to Lugano criteria (Cheson et al 2014) based on CT or MRI (or PET)., Solid tumors: • ORR, defined as the percentage of participants having CR or PR, as determined by investigator assessment of radiographic disease per tumors per RANO for CNS tumors or RECIST v1.1 for other solid tumors based on CT or MRI (or PET). • OS, defined as the interval between the date of the first dose of study treatment until the date of death from any cause., DOR, defined as the interval between the first assessment at which the criteria for response are met until the criteria for progression are met. • PFS, defined as the interval from the date of the first dose of study treatment until the date of progression of disease or death from any cause, whichever is earlier.

Source: https://euclinicaltrials.eu/ctis-public/view/2023-509699-41-00